EU clinical trial 2024-515310-40-01: Multicentric non-randomized phase II of pembrolizumab in combination with etoposide-cisplatin-based chemotherapy in first-line small cell ovarian carcinoma of hypercalcemic type
Protocol code: GINECO-OV243b
Sponsor: Asso De Recherche Cancers Gynecologiques (Laboratory/Research/Testing facility). Phase: Therapeutic exploratory (Phase II). Countries: France (ongoing, recruiting).
Therapeutic area(s): Diseases [C] - Neoplasms [C04]
Gender: Female. Age: 0-17 years, 18-64 years, 65+ years. Enrolment: 27.
Status: Ongoing, recruiting. Start date (EU): 2021-08-04. Decision date: 2024-10-01. Results received: No. Last updated: 2026-01-22.

Condition(s): Patients with a confirmed diagnosis of ovarian small cell carcinoma.
Product: Etoposide 20 mg/ml Concentrate for solution for infusion , KEYTRUDA 25 mg/mL concentrate for solution for infusion, Cisplatine Teva 1 mg/ml solution à diluer pour perfusion., ADRIBLASTINE 10 mg, poudre pour solution injectable en flacon, Cyclophosphamide Sandoz, 100 mg/mL, koncentrat do sporządzania roztworu do wstrzykiwań / do infuzji

Primary endpoint: Complete response rate is documented using RECIST 1.1
Endpoint(s): Safety will be assessed using NCI CTC-AE v5, Efficacy will be documented using RECIST 1.1.

Source: https://euclinicaltrials.eu/ctis-public/view/2024-515310-40-01